EU clinical trial 2023-508039-29-00: A Phase 2, Randomized, Double-blind, Placebo-controlled, Dose Ranging Study to Assess the Efficacy and Safety of Rocatinlimab in Adult Subjects With Moderate-to-severe Asthma
Protocol code: 20220093
Sponsor: Amgen Inc. (Pharmaceutical company). Phase: Therapeutic exploratory (Phase II). Countries: Romania (ended), Czechia (ended), Hungary (ended), Poland (ongoing, recruitment ended), Bulgaria (ended).
Therapeutic area(s): Diseases [C] - Respiratory Tract Diseases [C08]
Gender: Female, Male. Age: 18-64 years, 65+ years. Enrolment: 126.
Start date (EU): 2024-09-16. Decision date: 2024-08-23. Results received: No. Last updated: 2026-06-17.
Decision dates by country: RO: 2024-08-28, CZ: 2024-08-23, PL: 2024-08-27, BG: 2024-08-28, HU: 2024-08-27

Condition(s): Moderate-to-severe Asthma
Product: Placebo for AMG 451, Rocatinlimab

Primary endpoint: Annualized asthma exacerbation rate (AAER) during the placebo-controlled treatment period (blinded treatment period). Exacerbation events are defined as worsening of asthma requiring the use of systemic corticosteroids for ≥ 3 days, emergency department visit resulting in requirement for systemic corticosteroids for ≥ 3 days or an inpatient hospitalization due to asthma
Endpoint(s): Change from baseline in Asthma Symptom diary (ASD) score at assessment timepoints, Annualized rate of asthma exacerbation leading to hospitalization or emergency room visits during the blinded treatment period, Time to first asthma exacerbation event, Serum rocatinlimab concentrations at assessment timepoints

Source: https://euclinicaltrials.eu/ctis-public/view/2023-508039-29-00